EU clinical trial 2023-506290-35-00: Osprey: An Open-label Study to Investigate the Safety, Tolerability, and Exposure of Single Ascending Doses of the Antisense Oligonucleotide STK-002 in Patients with Autosomal Dominant Optic Atrophy
Protocol code: STK-002-OA-101
Sponsor: Stoke Therapeutics Inc. (Pharmaceutical company). Phase: Human Pharmacology (Phase I)- First administration to humans. Countries: Denmark (ongoing, recruiting), Austria (ongoing, recruiting), Germany (ongoing, recruiting), Italy (ongoing, recruiting).
Therapeutic area(s): Diseases [C] - Congenital, Hereditary, and Neonatal Diseases and Abnormalities [C16]
Gender: Female, Male. Age: 0-17 years, 18-64 years. Enrolment: 35.
Status: Ongoing, recruiting. Start date (EU): 2025-12-08. Decision date: 2024-04-03. Results received: No. Last updated: 2026-07-30.
Decision dates by country: DE: 2024-05-02, AT: 2024-05-06, DK: 2024-04-03, IT: 2024-09-02

Condition(s): Autosomal Dominant Optic Atrophy
Product: STK-002

Primary endpoint: Safety variables for analysis, The exposure of STK-002 in serum will be determined using Pharmacokinetic (PK) parameters
Endpoint(s): Peripapillary retinal nerve fiber layer (RNFL) and macular ganglion cell layer (GCL, or ganglion cell complex) thicknesses as assessed by optical coherence tomography (OCT), Best-corrected visual acuity (BCVA) using Early Treatment Diabetic Retinopathy Study (ETDRS) optotypes, Contrast sensitivity as assessed by low contrast BCVA (at 25% and 5% contrast levels), Visual field (as assessed by automated, static perimetry [10-2 Swedish Interactive Threshold Algorithm (SITA) FAST]) and 24-2 Short Wavelength Automated Perimetry [SWAP]), Electrical activity of the retina as assessed by phototopic negative response (PhNR) ERG (if available), Continuous text reading acuity as assessed by MNREAD Acuity Charts, Quality of life as measured by scores on the National Eye Institute Visual Function Questionnaire-25 (NEI-VFQ-25), Impact of Vision Impairment for Children (IVI-C), and the European Quality of Life-5 Dimensions (EQ-5D)/EQ-5D-Y questionnaire

Source: https://euclinicaltrials.eu/ctis-public/view/2023-506290-35-00